EU clinical trial 2024-511993-55-00: A randomised, double-blind, multicentre, international placebo-controlled phase II study aimed at investigating the efficacy and safety of a novel modified-release tablet formulation of colesevelam hydrochloride in patients with bile acid diarrhoea (BAD)
Protocol code: CB-01-33/01
Sponsor: Cosmo Technologies Limited (Pharmaceutical company). Phase: Therapeutic exploratory (Phase II). Countries: Denmark (ongoing, recruiting), Italy (ongoing, recruiting), Romania (ongoing, recruiting), Spain (ongoing, recruiting), Belgium (ongoing, recruiting).
Therapeutic area(s): Diseases [C] - Digestive System Diseases [C06]
Gender: Female, Male. Age: 18-64 years, 65+ years. Enrolment: 120.
Status: Ongoing, recruiting. Start date (EU): 2025-09-18. Decision date: 2025-05-27. Results received: No. Last updated: 2026-05-26.
Decision dates by country: IT: 2025-05-29, DK: 2025-05-27, RO: 2025-06-02, ES: 2025-05-30, BE: 2025-05-28

Condition(s): bile acid diarrhoea (BAD)
Product: Colesevelam hydrochloride-MMX® modified-release placebo tablets, Colesevelam hydrochloride-MMX® 900 mg modified-release tablets

Primary endpoint: Proportion of study participants, who are stool consistency responders at Week 8 after T1 or T2 as compared to P. A stool consistency responder is defined as a participant who experiences a ≥50% reduction in the number of days with at least one stool that has a consistency of Type 6 or 7 in the 7-point Bristol Stool Form Scale (BSFS) compared with baseline.
Endpoint(s): 01. Proportion of study participants, who are stool consistency responders at Week 2 and 4 after T1 or T2 as compared to P., 02. Proportion of study participants achieving remission of diarrhoea as per Hjortswang criteria, defined as <3 bowel movements per day and <1 stool per day with consistency of Type 6 or 7 in the 7-point BSFS calculated as the mean of the last 7 days prior to Week 8 after T1 or T2 as compared to P., 03. Proportion of study participants, who are stool frequency responders at Week 8 after T1 or T2 as compared to P. A stool frequency responder is defined as a participant, who experiences a ≥50% reduction in the number of days with ≥3 bowel movements compared with baseline, 04. Proportion of study participants who achieve remission in urgency, defined as a score of <3 in the urgency numerical rating scale at Week 2, 4 and 8 after treatment with T1 or T2 as compared to P., 05. To compare between treatments the proportion of study participants with and the number of adverse drug reactions after 8 weeks of treatment., 06. Use of rescue medication (loperamide 2 mg, oral use): number and proportion of users, and amount of used rescue medication.

Source: https://euclinicaltrials.eu/ctis-public/view/2024-511993-55-00